EU clinical trial 2025-524883-39-00: A Phase 1, open label, randomised, 2-period, 2 sequence, 7-days repeat-dosing, crossover oral pharmacokinetic trial comparing multiple dosing of CS014 to valproic acid in healthy adults.
Protocol code: CS014-002
Sponsor: Cereno Scientific AB (Pharmaceutical company). Phase: Human Pharmacology (Phase I)- Other. Countries: Sweden (ended).
Therapeutic area(s): Diseases [C] - Cardiovascular Diseases [C14]
Gender: Female, Male. Age: 18-64 years, 65+ years. Enrolment: 14.
Status: Ended. Start date (EU): 2026-05-04. End date (EU): 2026-07-06. Decision date: 2026-03-17. Results received: No. Last updated: 2026-03-17.

Condition(s): Cardiopulmonary diseases with contributions of thrombosis, remodelling of pulmonary vessels and fibrosis.

Source: https://euclinicaltrials.eu/ctis-public/view/2025-524883-39-00